EU clinical trial 2024-512207-39-00: A Phase 2, Multicenter, Randomized, Double-Blind, Placebo-Controlled, Parallel-Group, Dose-Ranging Study of LY4100511 (DC-853) for the Treatment of Adult Participants with Moderate-to-Severe Plaque Psoriasis
Protocol code: J5C-MC-FOAB
Sponsor: Dice Therapeutics Inc. (Pharmaceutical company). Phase: Therapeutic exploratory (Phase II). Countries: Hungary (ended), Poland (ended), Czechia (ended), Germany (ended).
Therapeutic area(s): Diseases [C] - Skin and Connective Tissue Diseases [C17]
Gender: Female, Male. Age: 18-64 years, 65+ years. Enrolment: 134.
Status: Ended. Start date (EU): 2025-01-30. End date (EU): 2025-08-27. End date: 2025-09-04. Decision date: 2025-01-23. Results received: Yes. Last updated: 2025-10-06.
Decision dates by country: PL: 2025-01-27, HU: 2025-01-24, DE: 2025-01-24, CZ: 2025-01-23

Condition(s): Plaque Psoriasis
Product: Placebo tablets will be the same size, shape, and color as the active tablets and will consist of the compendial excipients present in the active tablets. Placebo tablets are supplied in the same packaging configuration as the active tablets.

Primary endpoint: Proportion of participants achieving PASI 75 at Week 12
Endpoint(s): 1. Proportion of participants achieving: • an sPGA score of 0 or 1 with ≥2 grade improvement from baseline at Week 12 • ≥50%, ≥75%, ≥90%, and 100% reduction in PASI score at all scheduled timepoints • an sPGA score of 0 or 1 at all scheduled timepoints • Mean change and percent change from baseline in PASI score at all scheduled timepoints • Mean change and percent change from baseline in the percentage of BSA affected at all scheduled timepoints, 2. Summary of safety data, including number and proportion of: • TEAEs • SAEs • discontinuations due to TEAEs, 3. Measurement of plasma concentration of LY4100511 at scheduled timepoints to evaluate steady state maximum concentration (Cmax,ss) and trough concentration (Ctrough,ss) and associated intra-individual variability

Source: https://euclinicaltrials.eu/ctis-public/view/2024-512207-39-00